EU clinical trial 2023-506927-27-00: A study comparing the effect and safety of once weekly dosing of somapacitan with daily Norditropin® as well as evaluating long-term safety of somapacitan in a basket study design in children with short stature either born small for gestational age or with Turner syndrome, Noonan syndrome, or idiopathic short stature
Protocol code: NN8640-4467
Sponsor: Novo Nordisk A/S (Pharmaceutical company). Phase: Therapeutic confirmatory (Phase III). Countries: Austria (ended), Poland (ongoing, recruitment ended), Portugal (ongoing, recruitment ended), Spain (ongoing, recruitment ended), Croatia (ongoing, recruitment ended), Italy (ongoing, recruitment ended), Latvia (ongoing, recruitment ended), Finland (ongoing, recruitment ended), Greece (ongoing, recruitment ended), Germany (ongoing, recruitment ended), Netherlands (ongoing, recruitment ended), Slovenia (ongoing, recruitment ended), Lithuania (ongoing, recruitment ended), Bulgaria (ongoing, recruitment ended), France (ongoing, recruitment ended), Belgium (ongoing, recruitment ended).
Therapeutic area(s): Diseases [C] - Hormonal diseases [C19]
Gender: Female, Male. Age: 0-17 years. Enrolment: 135.
Start date (EU): 2022-08-29. Decision date: 2024-07-15. Results received: No. Last updated: 2026-07-16.
Decision dates by country: ES: 2024-07-17, PT: 2024-08-23, GR: 2024-07-22, IT: 2024-07-22, PL: 2024-08-04, NL: 2024-07-15, BG: 2024-07-18, FI: 2024-07-18, FR: 2024-07-22, DE: 2024-07-18, HR: 2024-07-19, AT: 2024-07-22, SI: 2024-07-19, LT: 2024-07-24, LV: 2024-08-08, BE: 2024-07-23

Condition(s): Children with short stature either born small for gestational age or with Turner syndrome, Noonan syndrome, or idiopathic short stature
Product: Norditropin FlexPro, injektionsvæske, opløsning i fyldt pen, Sogroya 5 mg/1.5 mL solution for injection in pre-filled pen, Sogroya 15 mg/1.5 mL solution for injection in pre-filled pen, Sogroya 10 mg/1.5 mL solution for injection in pre-filled pen

Primary endpoint: Height velocity
Endpoint(s): Change in Height SDS, Change in Height Velocity SDS, Change in bone age, Change in IGF-I SDS, Change in IGFBP-3 SDS, Change in fasting plasma glucose, Change in homeostatic model assessment-B (HOMA-B), Change in homeostatic model assessment-IR (HOMA-IR), Change in glycated haemoglobin (HbA1c), CCI

Source: https://euclinicaltrials.eu/ctis-public/view/2023-506927-27-00